EU clinical trial 2024-515899-13-00: Psilocybin versus ketamine – fast acting antidepressant strategies in treatment-resistant depression
Protocol code: PSIKET_001CZE
Sponsor: Narodni Ustav Dusevniho Zdravi (Hospital/Clinic/Other health care facility). Phase: Therapeutic exploratory (Phase II). Countries: Czechia (ongoing, recruitment ended).
Therapeutic area(s): Psychiatry and Psychology [F] - Mental Disorders [F03]
Gender: Female, Male. Age: 18-64 years. Enrolment: 60.
Status: Ongoing, recruitment ended. Start date (EU): 2024-11-21. Decision date: 2024-11-21. Results received: No. Last updated: 2026-07-08.

Condition(s): pharmaco-resistant depression

Primary endpoint: Evaluation of fast antidepressant effects of psilocybin versus ketamine.
Endpoint(s): Duration of the antidepressant effect of psilocybin, ketamine and midazolam using the MADRS scale during 2 weeks of inpatient stay, Duration of the antidepressant effect of psilocybin, ketamine and midazolam after termination of inpatient stay using the MADRS scale., Duration of the antidepressant effect of a single application of psilocybin, ketamine and midazolam using the QIDS scale., Comparison of response rates (50% reduction in MADRS scale) and remissions (MADRS ≤ 10) following psilocybin, ketamine and midazolam treatment, Time to reoccurrence of the depressive symptoms within 12 weeks (3 months) after treatment with psilocybin, ketamine and midazolam., Safety profile of study drug: a) acute (vital signs (BP/HR), BPRS, psilocin levels) b) longterm (BPRS, PSQ a Persistent effects scale)

Source: https://euclinicaltrials.eu/ctis-public/view/2024-515899-13-00